EU clinical trial 2022-501188-42-00: A Randomized, Double-blind, Placebo-controlled, Parallel-group, Multicenter Study with a Long-Term Extension Treatment Period to Assess the Efficacy and Safety of JNJ-63733657, an Anti-tau Monoclonal Antibody, in Participants with Early Alzheimer's Disease
Protocol code: 63733657ALZ2002
Sponsor: Janssen - Cilag International (Pharmaceutical company). Phase: Therapeutic exploratory (Phase II). Countries: Sweden (ended), France (ended), Belgium (ended), Netherlands (ended), Spain (ended).
Therapeutic area(s): Diseases [C] - Nervous System Diseases [C10]
Gender: Female, Male. Age: 18-64 years, 65+ years. Enrolment: 195.
Status: Ended. Start date (EU): 2021-04-15. End date (EU): 2026-03-03. End date: 2026-03-04. Decision date: 2022-11-11. Results received: No. Last updated: 2025-12-16.
Decision dates by country: NL: 2022-11-15, FR: 2022-11-14, ES: 2022-11-15, SE: 2022-11-11, BE: 2022-11-17

Condition(s): Early Alzheimer's Disease
Product: PL1, JNJ-63733657, JNJ-63733657, florquinitau F18

Primary endpoint: Change from baseline on the iADRS total score at week 104

Source: https://euclinicaltrials.eu/ctis-public/view/2022-501188-42-00